EU clinical trial 2022-501360-18-00: Randomized, Open-Label, Phase 3 Trial of Nivolumab plus Ipilimumab or Nivolumab plus Platinum-Doublet Chemotherapy versus Platinum-Doublet Chemotherapy in Early Stage NSCLC
Protocol code: CA209-816
Sponsor: Bristol-Myers Squibb International Corporation (Pharmaceutical company). Phase: Therapeutic confirmatory (Phase III). Countries: France (ended), Italy (ended), Romania (ended), Spain (ended).
Therapeutic area(s): Diseases [C] - Neoplasms [C04]
Gender: Female, Male. Age: 18-64 years, 65+ years. Enrolment: 194.
Status: Ended. Start date (EU): 2017-03-15. End date (EU): 2024-12-03. End date: 2024-12-13. Decision date: 2023-04-28. Results received: Yes. Last updated: 2024-12-03.
Decision dates by country: IT: 2023-05-03, RO: 2023-05-08, ES: 2023-04-28, FR: 2023-04-28

Condition(s): Early Stage Non-Small Cell Lung Cancer (NSCLC)
Product: OPDIVO 10 mg/mL concentrate for solution for infusion., Docetaxel Hospira 10 mg/ml Concentrate for Solution for Infusion, Vinorelbin NC 10 mg/ml - Konzentrat zur Herstellung einer Infusionslösung, Gemcitabine 38 mg/ml Concentrate for Solution for Infusion, Carboplatin Bendalis 10mg/ml, Konzentrat zur Herstellung einer Infusionslösung, TAXOL 6 mg/ml, concentrato per soluzione per infusione, Carbomedac® 10 mg/ml Konzentrat zur Herstellung einer Infusionslösung, CARBO-cell® 10 mg/ml Infusionslösung, Konzentrat zur Herstellung einer Infusionslösung Carboplatin, CISPLATIN-EBEWE, 1 MG/ML, KONCENTRAT DO SPORZĄDZANIA ROZTWORU DO INFUZJI, Ipilimumab, Paclitaxel-GRY® 6 mg/ml Konzentrat zur Herstellung einer Infusionslösung, Vinorelbin Aurobindo 10 mg/ml Konzentrat zur Herstellung einer Infusionslösung, Cisplatin Teva® 1 mg/ml Konzentrat zur Herstellung einer Infusionslösung, Paclitaxel Aurobindo 6 mg/ml Konzentrat zur Herstellung einer Infusionslösung, Gemcitabine 1 g Powder for Solution for Infusion, Ipilimumab, Bendatax 6 mg/ ml, Cisplatin NeoCorp 1 mg/ml - Konzentrat zur Herstellung einer Infusionslösung, Docetaxel-Ebewe, 10 mg/ml, koncentrat do sporządzania roztworu do infuzji, Navirel 10 mg/ml Konzentrat zur Herstellung einer Infusionslösung, OPDIVO 10 mg/mL concentrate for solution for infusion., ALIMTA 500 mg powder for concentrate for solution for infusion, Doce NC 10 mg/ml Konzentrat zur Herstellung einer Infusionslösung

Primary endpoint: Event-Free Survival, Pathological Complete Response
Endpoint(s): Overall survival (OS), Major pathological response (MPR), Time to Death or Distant Metastases (TTDM)

Source: https://euclinicaltrials.eu/ctis-public/view/2022-501360-18-00